EU clinical trial 2024-518040-21-00: A Phase 1 Trial Assessing Pharmacokinetics and Safety of CAM2056 (Semaglutide Subcutaneous Depot)
Protocol code: HS-24-787
Sponsor: Camurus AB (Pharmaceutical company). Phase: Human Pharmacology (Phase I)- First administration to humans. Countries: Germany (ended).
Therapeutic area(s): Diseases [C] - Nutritional and Metabolic Diseases [C18]
Gender: Female, Male. Age: 18-64 years. Enrolment: 80.
Status: Ended. Start date (EU): 2024-12-18. End date (EU): 2025-09-11. Decision date: 2024-12-10. Results received: No. Last updated: 2025-05-09.

Condition(s): Body weight management

Source: https://euclinicaltrials.eu/ctis-public/view/2024-518040-21-00